EU clinical trial 2024-519672-12-00: Deflazacort TREATment in LMNArelated congenital muscular dystrophy: study of clinical effectiveness and search for reliable biomarkers
Protocol code: TREAT LMNA
Sponsor: Azienda Ospedaliero Universitaria Pisana (Hospital/Clinic/Other health care facility). Phase: Therapeutic exploratory (Phase II). Countries: Italy (authorised, recruitment pending).
Therapeutic area(s): Diseases [C] - Nervous System Diseases [C10]
Gender: Female, Male. Age: 0-17 years, 18-64 years. Enrolment: 20.
Status: Authorised, recruitment pending. Decision date: 2025-01-21. Results received: No. Last updated: 2025-01-21.

Condition(s): Laminopathies
Product: DEFLAN 22,75 mg/ml gocce orali, sospensione

Primary endpoint: Evaluation of the effects of treatment with Deflazacort drops (0.9mg/kg/day in relation to the change of clinical parameters at each treatment time and follow up (T0-T6-T12-T15-T18).

Source: https://euclinicaltrials.eu/ctis-public/view/2024-519672-12-00